EU clinical trial 2024-519539-41-00: Is there an effect of local vaginal estrogen treatment on the hemostatic parameters in postmenopausal women?
Sponsor: Aarhus University Hospital (Hospital/Clinic/Other health care facility). Phase: Therapeutic use (Phase IV). Countries: Denmark (ongoing, recruiting).
Therapeutic area(s): Diseases [C] - Female Urogenital Diseases and Pregnancy Complications [C13]
Gender: Female. Age: 18-64 years, 65+ years. Enrolment: 90.
Status: Ongoing, recruiting. Start date (EU): 2025-05-13. Decision date: 2025-03-26. Results received: No. Last updated: 2025-03-26.

Condition(s): Treatment for vaginal atrophy
Product: ESTRADIOL

Primary endpoint: Compare changes in thrombin generation and fibrinolysis in postmenopausal women with and without VTE using vaginal estrogen in three months
Endpoint(s): Compare changes in contact activation system in women receiving vaginal estrogen in three months

Source: https://euclinicaltrials.eu/ctis-public/view/2024-519539-41-00